EU clinical trial 2022-502502-32-00: Safety of ibuprofen after major orthopaedic surgeries - the PERISAFE randomized clinical multicentre trial
Sponsor: Slagelse Hospital (Hospital/Clinic/Other health care facility). Phase: Phase III and phase IV (Integrated). Countries: Denmark (ended).
Therapeutic area(s): Analytical, Diagnostic and Therapeutic Techniques and Equipment [E] - Anesthesia and Analgesia [E03]
Gender: Female, Male. Age: 18-64 years, 65+ years. Enrolment: 2904.
Status: Ended. Start date (EU): 2023-04-17. End date (EU): 2026-05-27. Decision date: 2023-03-17. Results received: No. Last updated: 2025-03-31.

Condition(s): Hip and knee arthroplasties, Acute postoperative pain
Product: Identical capsule, Ibuprofen 400 mg, tabletten

Primary endpoint: A composite outcome of either death, acute myocardial infarction, stroke, pulmonary embolism, deep venous thrombosis, renal failure, major bleeding, re-operation, gastrointestinal ulcer, or readmission within 90 days postoperatively.
Endpoint(s): Hospital free days within 90 days postoperatively., A composite outcome of ibuprofen related adverse events based on eight-day postoperative diary: pain or discomfort from the epigastrium, reflux, diarrhoea., A composite outcome of opioid related adverse events based on eight-day postoperative diary: nausea, vomiting, constipation, sedation, headache, mood changes, mouth dryness., Health related quality of life questionnaire via EQ-5D-5L after 90 days and one year postoperatively.

Source: https://euclinicaltrials.eu/ctis-public/view/2022-502502-32-00